EU clinical trial 2024-514428-18-00: (Pre-BCGvacc) BCG vaccination: can pre-vaccination immune status predict outcome?
Sponsor: Leids Universitair Medisch Centrum (LUMC) (Hospital/Clinic/Other health care facility). Phase: Phase III and phase IV (Integrated). Countries: Netherlands (ongoing, recruiting).
Therapeutic area(s): Diseases [C] - Bacterial Infections and Mycoses [C01]
Gender: Female, Male. Age: 18-64 years. Enrolment: 50.
Status: Ongoing, recruiting. Start date (EU): 2025-10-24. Decision date: 2025-07-21. Results received: No. Last updated: 2025-12-12.

Condition(s): health volunteerst
Product: Rabipur, BCG VACCINE AJV por és oldószer szuszpenziós injekcióhoz BCG vakcina, fagyasztva szárított

Primary endpoint: Induction of mycobacterial growth control measured in vitro by MGIA (1 log reduction post vaccination compared to inoculum). Level of control in MGIA will be used as classifier to assess pre-vaccination functional status.
Endpoint(s): Imaging of dermal biopsies and correlation of relative subset distribution with functional mycobacterial growth control in MGIA. Frequencies of subsets in the dermis will be correlated with MGIA control capacity., Correlates of protection for both BCG (MGIA as best available correlate) and Rabipur (neutralizing antibodies) vaccinations will be compared and correlated., Correlation between cell frequencies and functional read outs prevaccination and at multiple post vaccination time points, Correlation of metabolic state to effector immune responses such as measured by MGIA and intracellular cytokine secretion.

Source: https://euclinicaltrials.eu/ctis-public/view/2024-514428-18-00